EU clinical trial 2024-513760-26-00: A Phase 2 Study Evaluating Futibatinib (TAS-120) Plus Pembrolizumab in the Treatment of Advanced or Metastatic Urothelial Carcinoma
Protocol code: TAS-120-203
Sponsor: Taiho Oncology Inc. (Pharmaceutical company). Phase: Therapeutic exploratory (Phase II). Countries: France (ended).
Therapeutic area(s): Diseases [C] - Neoplasms [C04]
Gender: Female, Male. Age: 18-64 years, 65+ years. Enrolment: 15.
Status: Ended. Start date (EU): 2021-09-07. End date (EU): 2025-09-16. End date: 2025-09-17. Decision date: 2024-07-15. Results received: Yes. Last updated: 2025-05-19.

Condition(s): Advanced or Metastatic Urothelial Carcinoma
Product: Futibatinib, KEYTRUDA 25 mg/mL concentrate for solution for infusion

Primary endpoint: Objective response rate (ORR), defined as the proportion of patients experiencing a best overall response of complete response (CR) or partial response (PR).
Endpoint(s): -Disease control rate (DCR), defined as the proportion of patients experiencing a best overall response of stable disease (SD), PR, or CR., ·Duration of response (DOR), defined as the time from the first documentation of response (CR or PR) to the first documentation of objective tumor progression or death due to any cause, whichever occurs first., ·Progression-free survival (PFS), defined as the time from the first dose of study therapy to the date of death (any cause) or disease progression, whichever occurs first., ·Overall survival (OS), defined as the time from the date of the first dose to the death date., ·Safety and tolerability, based on reported adverse events (AEs) and on-study laboratory parameters, graded according to the National Cancer Institute – Common Terminology Criteria for Adverse Events (NCI-CTCAE), Version 5.0.

Source: https://euclinicaltrials.eu/ctis-public/view/2024-513760-26-00